EU clinical trial 2024-513771-40-01: Eight-Treg study: a phase I dose escalation trial of adoptive immunotherapy with autologous ex vivo expanded regulatory CD8+ T cells in living donor kidney transplant recipients
Protocol code: RC24_0033
Sponsor: Centre Hospitalier Universitaire De Nantes (Hospital/Clinic/Other health care facility). Phase: Phase I and Phase II (Integrated)- First administration to humans. Countries: France (ongoing, recruiting).
Therapeutic area(s): Not possible to specify
Gender: Female, Male. Age: 18-64 years, 65+ years. Enrolment: 9.
Status: Ongoing, recruiting. Start date (EU): 2025-03-03. Decision date: 2024-12-20. Results received: No. Last updated: 2024-12-20.

Condition(s): chronic renal failure requiring kidney transplantation
Product: CETIRIZINE ARROW CONSEIL 10 mg, comprimé pelliculé sécable, METHYLPREDNISOLONE VIATRIS 500 mg, poudre pour solution injectable, Mycophenolate mofetil Sandoz 250 mg capsules, hard, Eight Treg, PREDNISONE ARROW 20 mg, comprimé sécable, Prograf 5 mg/ml concentrate for solution for infusion, Myfortic 180 mg comprimés gastro-résistants

Primary endpoint: Occurrence of a dose-limiting toxicity up to visit 10, at 3 months post-graft. A Dose-Limiting Toxicity (DLT) is defined as a clinically significant AE or abnormal laboratory value: • Unrelated to the kidney transplant, intercurrent illness, or concomitant medications • Grade 3, 4 or 5 non-hematologic toxicity (with exceptions)
Endpoint(s): Occurrence of a DLT up to 6- and 12-months post-graft, and anatomopathological and im-munohistological (HD) analysis of the graft biopsies at 1- and 3-months post-graft., Incidence, duration and severity of infections, and total immunosuppressive burden at one-year post-graft., 3 Real time follow-up of blood cell count, analysis of the DSA and of cytokines in plasma and urine; kinetic of absolute count of blood cells and high density spectral immunophenotyping at protein and transcriptional levels of PBMC; tracking the infused cells in blood; identifying Tregs clones emerging; evaluating the suppressive capacity of circulating Tregs; evaluating the reac-tivity of circulating T cells ; immunohistochemical staining and spatial transcriptomic of graft biopsies, 4 Comparison of blood Tregs profile, emerging clones, and donor reactive T cells; and perturba-tion of graft infiltrate after cell therapy compared to standard treatment from a control biocollec-tion (DIVAT declared on 09/05/2011 under the n°DC-2011-1399) and historical databases.

Source: https://euclinicaltrials.eu/ctis-public/view/2024-513771-40-01